EU clinical trial 2022-501549-57-00: Percutaneous Needle Fasciotomy +/- Corticosteroid Injection for Dupuytren Contracture Affecting the Metacarpophalangeal Joint. A Randomized Controlled Trial.
Protocol code: 2022-985
Sponsor: Region Midtjylland (Hospital/Clinic/Other health care facility). Phase: Therapeutic confirmatory (Phase III). Countries: Denmark (ongoing, recruiting).
Therapeutic area(s): Diseases [C] - Skin and Connective Tissue Diseases [C17]; Diseases [C] - Musculoskeletal Diseases [C05]
Gender: Female, Male. Age: 18-64 years, 65+ years. Enrolment: 400.
Status: Ongoing, recruiting. Start date (EU): 2023-01-10. Decision date: 2022-10-12. Results received: No. Last updated: 2026-02-09.

Condition(s): Dupuytren Concrature
Product: 2 ml of isotonic saline injection (9 mg/ml), Depo-Medrol 40 mg/1 ml Injektionssuspension, XYLOCAINE 10 mg/ml SANS CONSERVATEUR, solution injectable

Primary endpoint: Recurrence, defined as ≥20° passive extension deficit in metacarpophalangeal joint
Endpoint(s): %-change in metacarpophalangeal (MCP) joint passiv exension deficit (PED), Straight MCP joint (0-5°), Passive extension deficit of MCP, PIP, DIP-joints, Total passive extension deficit, Maximal pulp-to-palm distance (mm), Tabletop test, Complications and Adverse Events (AEs), Reoperation, PROM score: "quick-DASH", "Southhampton Dupuytren Scoring Scheme", EQ-5D (EuroQol five dimension scale) for cost-benefit analysis, Global rating of change scale for patient satisfaction

Source: https://euclinicaltrials.eu/ctis-public/view/2022-501549-57-00